EU clinical trial 2024-514149-12-00: Double blind randomized clinical trial comparing noradrenaline plus placebo versus noradrenaline plus terlipressin in septic shock.
Protocol code: CONTENTSS
Sponsor: Fundacion Publica Andaluza Para La Gestion De La Investigacion En Salud De Sevilla (Laboratory/Research/Testing facility). Phase: Therapeutic confirmatory (Phase III). Countries: Spain (ended).
Therapeutic area(s): Diseases [C] - Bacterial Infections and Mycoses [C01]
Gender: Female, Male. Age: 18-64 years, 65+ years. Enrolment: 152.
Status: Ended. Start date (EU): 2024-06-26. End date (EU): 2024-12-28. Decision date: 2024-06-04. Results received: Yes. Last updated: 2024-08-29.

Condition(s): Septic Shock
Product: NOREPINEPHRINE, Terlipresina acetato EVER Pharma 1 mg solución inyectable, Solution in a vial with the same external appearance as terlipressin

Primary endpoint: Reduction of organ failure evaluated by SOFA scale, Increase in ICU-free days of life
Endpoint(s): Increase in lactate clearance., Increase of the days with life free of mechanical ventilation., Increase in vasopressor-free days of life, Mortality, Reduction of the need for continuous renal replacement therapy (CRRT)., Reduction of the total equivalent dose of vasopressors, No increase in adverse effects related to the administration of vasopressors, Association of mortality with genetic variants of the vasopressin 1a receptor and the LNPEP gene., Association between the achievement of the combined primary endpoint and the genetic variants of the vasopressin receptor 1a and the LNPEP gene., Association between the appearance of adverse effects due to the use of terlipressin, and the genetic variants of the Vasopressin 1a receptor and LNPEP gene.

Source: https://euclinicaltrials.eu/ctis-public/view/2024-514149-12-00